EU clinical trial 2026-525696-77-00: A study in healthy people to test how Zongertinib is taken up in the body when given as tablets made by two different manufacturers with or without food
Protocol code: 1479-0067
Sponsor: Boehringer Ingelheim International GmbH (Pharmaceutical company). Phase: Human Pharmacology (Phase I)- Bioequivalence Study. Countries: Germany (authorised, recruitment pending).
Therapeutic area(s): Not possible to specify
Gender: Female, Male. Age: 18-64 years. Enrolment: 56.
Status: Authorised, recruitment pending. Decision date: 2026-08-07. Results received: No. Last updated: 2026-08-07.

Condition(s): Healthy

Source: https://euclinicaltrials.eu/ctis-public/view/2026-525696-77-00